EU clinical trial 2025-524816-13-00: A Phase 2 Study Evaluating the Safety and Efficacy of Neoadjuvant Amivantamab in Combination with Lazertinib or Chemotherapy in Resectable EGFR-Mutated Non-Small Cell Lung Cancer
Protocol code: 61186372PANSC2005
Sponsor: Janssen Cilag International (Pharmaceutical company). Phase: Therapeutic exploratory (Phase II). Countries: Spain (authorised, recruiting).
Therapeutic area(s): Diseases [C] - Neoplasms [C04]
Gender: Female, Male. Age: 18-64 years, 65+ years. Enrolment: 6.
Status: Authorised, recruiting. Start date (EU): 2026-07-27. Decision date: 2026-07-27. Results received: No. Last updated: 2026-07-27.

Condition(s): Non-small Cell Lung Cancer
Product: JNJ-73841937, JNJ-61186372

Primary endpoint: MPR (≤10% residual cancer cells in the surgical specimen, per independent centralized pathology review)

Source: https://euclinicaltrials.eu/ctis-public/view/2025-524816-13-00